EU clinical trial 2024-519774-40-00: Effect of Mediterranean diet combined with intermittent fasting on liver fibrosis compared to naltrexone/bupropion (Mysimba) in people with cardiometabolic risk factors
Sponsor: Sint Franciscus Vlietland Groep Stichting (Hospital/Clinic/Other health care facility). Phase: Therapeutic use (Phase IV). Countries: Netherlands (authorised, recruitment pending).
Therapeutic area(s): Diseases [C] - Nutritional and Metabolic Diseases [C18]
Gender: Female, Male. Age: 18-64 years, 65+ years. Enrolment: 70.
Status: Authorised, recruitment pending. Decision date: 2025-01-30. Results received: No. Last updated: 2025-10-16.

Condition(s): People with a Body Mass Index (BMI) of 30 kg/m2 or more (obese), or 27 kg/m2 to 30 kg/m2 in the presence of one or more weight-related comorbidities (e.g. type 2 diabetes, dislipidaemia or regulated hypertension)
Product: Mysimba 8 mg/90 mg prolonged-release tablets

Primary endpoint: Between-group difference in liver fibrosis during six months. Liver fibrosis will be measured as liver stiffness (kPa) by transient elastography (TE) (FibroScan®)
Endpoint(s): Liver steatosis (CAP score, FibroScan), Nutritional assessment: Body weight (kg), height (cm), waist circumference (cm), fat mass and lean body mass measured with bioelectrical impedance analysis (kg), grip strength (kg), Cardiovascular risk factors: total cholesterol, LDL cholesterol, HDL cholesterol, triglycerides, apolipoprotein B (ApoB), apolipoprotein AI (ApoAI), lipoprotein (a), HbA1c, fasting blood glucose, fasting insulin and blood pressure, measured with routine lab procedures, Other laboratory measurements, measured with routine lab procedures. Among others the following routine measurements will be done: creatinine, estimated GFR (eGFR), alanine aminotransferase (ALAT), aspartate aminotransferase (ASAT), thrombocytes, haemoglobin (Hb), leukocytes, transferrin and ferritin, total iron binding capacity, apolipoprotein B48 (ApoB48), fibroblast growth factor 19 (FGF19) and 21 (FGF21), C-reactive protein (CRP), fibrosis-4 index score (Fib-4), Physical activity, Quality of life, Patient satisfaction, Food intake and adherence to the dietary intervention, Demographic variables, drug use, smoking and drinking habits, (diabetes) medication use and compliance to the time restriction

Source: https://euclinicaltrials.eu/ctis-public/view/2024-519774-40-00